EU clinical trial 2024-518839-11-00: KEYMAKER-U01 Substudy 01I: A Phase 2, Randomized, Umbrella Study With Rolling Arms of Investigational Agents in Participants with Previously Treated Stage IV Squamous Non-small Cell Lung Cancer (NSCLC)
Protocol code: MK-3475-01I
Sponsor: Merck Sharp & Dohme LLC (Pharmaceutical company). Phase: Therapeutic exploratory (Phase II). Countries: Greece (ongoing, recruiting), Poland (ongoing, recruiting), Hungary (ongoing, recruiting), Germany (ongoing, recruiting), Spain (ongoing, recruiting), Italy (ongoing, recruiting).
Therapeutic area(s): Diseases [C] - Neoplasms [C04]
Gender: Female, Male. Age: 18-64 years, 65+ years. Enrolment: 72.
Status: Ongoing, recruiting. Start date (EU): 2025-08-25. Decision date: 2025-08-13. Results received: No. Last updated: 2026-07-14.
Decision dates by country: HU: 2025-08-18, IT: 2025-08-14, GR: 2025-08-14, DE: 2025-08-13, PL: 2025-08-18, ES: 2025-08-13

Condition(s): Stage IV Squamous Non-Small Cell Lung Cancer
Product: Raludotatug Deruxtecan, DOCETAXEL, Ifinatamab Deruxtecan

Primary endpoint: Objective Response Rate (ORR), Number of participants who experience one or more adverse events (AEs), Number of participants who discontinue study intervention due to an AE
Endpoint(s): Duration of Response (DOR), Progression-free Survival (PFS), Overall Survival (OS)

Source: https://euclinicaltrials.eu/ctis-public/view/2024-518839-11-00